EU clinical trial 2024-513365-39-00: A randomized, double-blind, placebo-controlled trial comparing the efficacy and tolerance of solriamfetol in patients affected with idiopathic hypersomnia. SOLR-IH
Protocol code: RECMPL23_0432
Sponsor: Centre Hospitalier Universitaire De Montpellier (Hospital/Clinic/Other health care facility). Phase: Therapeutic exploratory (Phase II). Countries: France (authorised, recruitment pending).
Therapeutic area(s): Diseases [C] - Nervous System Diseases [C10]
Gender: Female, Male. Age: 18-64 years. Enrolment: 60.
Status: Authorised, recruitment pending. Decision date: 2024-07-11. Results received: No. Last updated: 2026-07-23.

Condition(s): idiopathic hypersomnia

Source: https://euclinicaltrials.eu/ctis-public/view/2024-513365-39-00